EU clinical trial 2023-509047-26-00: Phase 1 First in Human Study to Explore AMG 355 as Monotherapy and in Combination with Pembrolizumab in Subjects with Advanced Solid Tumors
Protocol code: 20220028
Sponsor: Amgen Inc. (Pharmaceutical company). Phase: Human Pharmacology (Phase I)- First administration to humans. Countries: Poland (ended), Spain (ended), France (ended), Netherlands (ended).
Therapeutic area(s): Diseases [C] - Neoplasms [C04]
Gender: Female, Male. Age: 18-64 years, 65+ years. Enrolment: 135.
Status: Ended. Start date (EU): 2024-06-13. End date (EU): 2026-07-17. End date: 2026-07-22. Decision date: 2024-05-16. Results received: No. Last updated: 2026-03-09.
Decision dates by country: ES: 2024-05-16, FR: 2024-05-22, NL: 2024-06-07, PL: 2024-05-20

Condition(s): Dose Escalation: Non-small cell lung cancer (NSCLC), colorectal cancer (CRC), gastric cancer (GC), melanoma (MEL). Dose Confirmation: Lead Indication based on data from dose escalation. Dose Expansion: Tertiary Lymphoid Structure positive (TLS+) CRC, GC, and NSCLC.

Source: https://euclinicaltrials.eu/ctis-public/view/2023-509047-26-00